EU clinical trial 2024-516558-24-00: SARUPANC - A multicentric, single arm, phase II trial assessing the efficacy of suraparib as first line therapy for patients with metastatic homologous repair-deficient pancreatic cancer
Protocol code: SARUPANC/ET24-201
Sponsor: Centre Leon Berard (Hospital/Clinic/Other health care facility). Phase: Therapeutic exploratory (Phase II). Countries: France (ended).
Therapeutic area(s): Diseases [C] - Neoplasms [C04]
Gender: Female, Male. Age: 18-64 years, 65+ years. Enrolment: 700.
Status: Ended. End date (EU): 2026-01-27. Decision date: 2026-01-23. Results received: Yes. Last updated: 2026-01-23.

Condition(s): Pancreatic (PAAD)
Product: Saruparib

Primary endpoint: Objective response rate at Week 16 (ORR-16W) according to RECIST V1.1
Endpoint(s): • DCR after 16 weeks of treatment (DRC-16W) according to RECIST V1.1 • Best overall response Rate according to RECIST V1.1 • Duration of response (DoR), • Progression Free survival (PFS) • Overall survival (OS), Incidence and severity of AEs (with severity determined according to NCI CTCAE v5.0) including AE related to vital signs and clinical laboratory test results., Changes from baseline in Quality of Life using European Organisation for Research and Treatment of Cancer (EORTC) QLQ-C30 questionnaire

Source: https://euclinicaltrials.eu/ctis-public/view/2024-516558-24-00